EU clinical trial 2024-520203-41-00: A Phase 1 Study of WVE-007 in Adults Living with Overweight or Obesity
Protocol code: WVE-007-001
Sponsor: Wave Life Sciences Ireland Limited (Pharmaceutical company). Phase: Human Pharmacology (Phase I)- First administration to humans. Countries: Romania (ongoing, recruiting).
Therapeutic area(s): Diseases [C] - Nutritional and Metabolic Diseases [C18]
Gender: Female, Male. Age: 18-64 years. Enrolment: 34.
Status: Ongoing, recruiting. Start date (EU): 2025-07-25. Decision date: 2025-06-23. Results received: No. Last updated: 2025-08-29.
Decision dates by country: RO: 2025-07-04

Condition(s): Adults Living with Overweight and Obesity

Source: https://euclinicaltrials.eu/ctis-public/view/2024-520203-41-00